EU clinical trial 2022-502352-31-00: Phase 3 Multicenter, Randomized, Open-label, Active-controlled Study of Sotorasib, Panitumumab and FOLFIRI Versus FOLFIRI With or Without Bevacizumab-awwb for Treatment-naïve Subjects With Metastatic Colorectal Cancer With KRAS p.G12C Mutation (CodeBreaK 301)
Protocol code: 20210081
Sponsor: Amgen Inc. (Pharmaceutical company). Phase: Therapeutic confirmatory (Phase III). Countries: Poland (ongoing, recruiting), Belgium (ongoing, recruiting), Netherlands (ongoing, recruiting), Austria (ongoing, recruiting), Hungary (ongoing, recruiting), Germany (ongoing, recruiting), Bulgaria (ongoing, recruiting), Sweden (ongoing, recruiting), Romania (ongoing, recruiting), Italy (ongoing, recruiting), Denmark (ongoing, recruiting), Greece (ongoing, recruiting), France (ongoing, recruiting), Estonia (ended), Spain (ongoing, recruiting), Portugal (ongoing, recruiting), Czechia (ongoing, recruiting), Slovakia (ongoing, recruiting).
Therapeutic area(s): Diseases [C] - Neoplasms [C04]
Gender: Female, Male. Age: 18-64 years. Enrolment: 241.
Start date (EU): 2025-02-10. Decision date: 2024-07-29. Results received: No. Last updated: 2026-07-30.
Decision dates by country: AT: 2024-08-05, BE: 2024-07-30, CZ: 2024-08-01, EE: 2024-08-02, FR: 2024-08-05, DE: 2024-07-29, HU: 2024-08-02, IT: 2024-07-31, PT: 2024-07-30, ES: 2024-08-01, NL: 2024-07-31, DK: 2024-07-29, PL: 2024-08-04, SE: 2024-08-01, SK: 2025-05-29, GR: 2024-07-29, RO: 2024-08-05, BG: 2024-07-30

Condition(s): Colorectal Cancer (CRC)
Product: PANITUMUMAB, CALCIUM FOLINATE, BEVACIZUMAB, FLUOROURACIL, SOTORASIB, BEVACIZUMAB, IRINOTECAN HYDROCHLORIDE TRIHYDRATE

Primary endpoint: PFS, defined as time from randomization until disease progression or death from any cause, whichever occurs first. Progression will be based on blinded independent central review (BICR) of disease response per Response Evaluation Criteria in Solid Tumors Version 1.1 (RECIST v1.1).
Endpoint(s): OS, defined as time from randomization until death from any cause, Objective response rate (ORR), defined as proportion of complete response (CR) + partial response (PR), assessed per RECIST v1.1 by BICR. CR and PR require confirmatory repeat assessment at least 4 weeks after the first detection of response., Duration of response (DOR) per RECIST v1.1 by BICR, defined as the time from the first documentation of objective response until the first documentation of disease progression or death from any cause, whichever occurs first., Disease control rate (DCR), defined as proportion of CR + PR + stable disease (SD) per RECIST v1.1 by BICR. Minimum time interval for determination of SD is 7 weeks from randomization date, Time to response (TTR), defined as the time from randomization to first documentation of objective response per RECIST v1.1 by BICR., Depth of response per RECIST v1.1 by BICR, defined as best percent change from baseline in sum of lesion diameters., Early tumor shrinkage (ETS) by BICR, defined as achieving at least 30% reduction in tumor size at first post-baseline assessment (at least 7 weeks from randomization date)., PFS, ORR, DOR, DCR, TTR, depth of response and ETS based on investigator’s assessment per RECIST v1.1, if applicable., Incidence and severity of treatment-emergent adverse events, changes in vital signs, and changes in clinical laboratory tests., PK parameters of sotorasib including, post-dose and pre-dose concentrations, as applicable.

Source: https://euclinicaltrials.eu/ctis-public/view/2022-502352-31-00